EU clinical trial 2024-511190-30-00: The QUEEN-IVF trial: Quinidine versus verapamil in short-coupled idiopathic ventricular fibrillation: An open-label, randomized crossover pilot trial
Sponsor: Amsterdam UMC (Hospital/Clinic/Other health care facility). Phase: Therapeutic exploratory (Phase II). Countries: Netherlands (authorised, recruiting).
Therapeutic area(s): Diseases [C] - Cardiovascular Diseases [C14]
Gender: Female, Male. Age: 18-64 years, 65+ years. Enrolment: 24.
Status: Authorised, recruiting. Start date (EU): 2024-11-25. Decision date: 2024-02-20. Results received: No. Last updated: 2025-04-09.

Condition(s): Short-coupled Idiopathic Ventricular Fibrillation
Product: VERAPAMIL, QUINIDINE

Primary endpoint: The primary endpoint is sustained ventricular arrhythmia, assessed using the severity scoring system. A subject will be scored in each treatment period according to the scoring system by the ECC. The highest applicable score will be used

Source: https://euclinicaltrials.eu/ctis-public/view/2024-511190-30-00